EU clinical trial 2024-511381-36-00: A phase IIIb, multi-center, open-label, treatment optimization study of oral asciminib in patients with Chronic Myelogenous Leukemia in chronic phase (CMLCP) previously treated with 2 or more tyrosine kinase inhibitors
Protocol code: CABL001A2302
Sponsor: Novartis Pharma AG (Pharmaceutical company). Phase: Therapeutic confirmatory (Phase III). Countries: Spain (ended), France (ended), Poland (ended), Germany (ended), Italy (ended), Austria (ended), Greece (ended).
Therapeutic area(s): Diseases [C] - Neoplasms [C04]
Gender: Female, Male. Age: 18-64 years, 65+ years. Enrolment: 108.
Status: Ended. Start date (EU): 2021-10-13. End date (EU): 2026-02-06. End date: 2026-02-25. Decision date: 2024-06-14. Results received: No. Last updated: 2025-10-20.
Decision dates by country: IT: 2024-06-19, FR: 2024-06-14, GR: 2024-07-22, AT: 2024-06-19, ES: 2024-06-17, PL: 2024-06-17, DE: 2024-06-17

Condition(s): Chronic Myelogenous Leukemia in chronic phase (CML-CP)
Product: ASCIMINIB HYDROCHLORIDE, ASCIMINIB

Primary endpoint: MMR at 48 weeks
Endpoint(s): Type, frequency and severity of adverse events, changes in laboratory values that fall outside the pre-determined ranges and clinically notable ECG and other safety data (vital signs, physical examination)., MMR rate at weeks 12, 24, 36, 72, 96 and 144., MMR rate at week 48 for patients with MMR at baseline., Time from the date of randomization to the date of first documented MMR, Rate of BCR-ABL1 ≤ 10% and ≤1% at weeks 12, 24, 36 and 48, Rate of MR4 and MR4.5 at weeks 12, 24, 36, 48, 72, 96 and 144., Rate of complete cytogenetic response (CCyR) at weeks 48 and EOT., Additional chromosomal abnormalities and occurrence of high-risk ACAs, Rate of BCR-ABL1 ≤ 10%, BCR-ABL1 ≤1%, MMR, MR4 and MR4.5 by all-time points., Duration of MMR., Duration of MR4 without loss of MMR., Time from randomization to death., Time from randomization to treatment failure defined as BCR-ABL1 > 1%., Change in symptom burden and interference from baseline over time according to the MDASI-CML PRO instrument., Time from randomization to the earliest occurrence of documented disease progression to AP/BC or death

Source: https://euclinicaltrials.eu/ctis-public/view/2024-511381-36-00